EU clinical trial 2023-503795-24-00: First in human study of BAY2927088 in participants who have advanced non-small cell lung cancer (NSCLC) with mutations in the genes of epidermal growth factor receptor (EGFR) and/or human epidermal growth factor receptor 2 (HER2)
Protocol code: 21607
Sponsor: Bayer AG (Pharmaceutical company). Phase: Phase I and Phase II (Integrated)- First administration to humans. Countries: Netherlands (ongoing, recruitment ended), Spain (ongoing, recruitment ended), Belgium (ongoing, recruitment ended), Italy (ongoing, recruitment ended), Portugal (ongoing, recruiting), France (ongoing, recruitment ended), Poland (ended).
Therapeutic area(s): Diseases [C] - Neoplasms [C04]
Gender: Female, Male. Age: 18-64 years, 65+ years. Enrolment: 120.
Start date (EU): 2022-09-16. Decision date: 2023-07-26. Results received: No. Last updated: 2026-05-19.
Decision dates by country: PL: 2023-09-05, PT: 2023-09-04, BE: 2023-07-28, IT: 2023-08-07, NL: 2023-07-26, ES: 2023-07-28, FR: 2023-09-04

Condition(s): Avanced Non-Small Cell Lung Cancer

Source: https://euclinicaltrials.eu/ctis-public/view/2023-503795-24-00